EU clinical trial 2023-504055-27-00: A study to evaluate the effect of multiple doses of carbamazepine and itraconazole on how long JNJ-55308942 stays in the body (pharmacokinetics) in healthy adults.
Sponsor: Janssen - Cilag International (Pharmaceutical company). Phase: Human Pharmacology (Phase I)- Other. Countries: Belgium (ended).
Therapeutic area(s): Psychiatry and Psychology [F] - Mental Disorders [F03]
Gender: Female, Male. Age: 18-64 years. Enrolment: 48.
Status: Ended. End date (EU): 2025-02-12. Decision date: 2023-10-10. Results received: No. Last updated: 2024-06-24.

Condition(s): Bipolar depression

Source: https://euclinicaltrials.eu/ctis-public/view/2023-504055-27-00